EU clinical trial 2024-517681-41-00: A Phase 1 Study of Healthy Donor CD19-targeted Allogeneic CAR T Cells in Participants with Severe, Refractory Autoimmune Diseases
Protocol code: IM060-0001
Sponsor: Bristol-Myers Squibb Services Unlimited Company (Pharmaceutical company). Phase: Human Pharmacology (Phase I)- First administration to humans. Countries: Germany (ongoing, recruiting), Romania (authorised, recruiting), France (authorised, recruiting), Spain (ongoing, recruiting), Czechia (ongoing, recruiting), Poland (ongoing, recruiting).
Therapeutic area(s): Diseases [C] - Immune System Diseases [C20]
Gender: Female, Male. Age: 18-64 years, 65+ years. Enrolment: 93.
Start date (EU): 2025-08-29. Decision date: 2025-07-16. Results received: No. Last updated: 2026-05-27.
Decision dates by country: CZ: 2025-07-30, FR: 2025-07-21, DE: 2025-07-17, RO: 2025-07-21, ES: 2025-07-22, PL: 2025-07-23

Condition(s): Systemic Sclerosis, Idiopathic Inflammatory Myopathy, Rheumatoid Arthritis, Systemic Lupus Erythematosus

Source: https://euclinicaltrials.eu/ctis-public/view/2024-517681-41-00